EU clinical trial 2024-518789-29-00: ADMSC-fib safety and efficacy in patients with chronico wounds
Protocol code: FJD-UHC-19-01
Sponsor: Instituto De Investigacion Sanitaria Fundacion Jimenez Diaz (Laboratory/Research/Testing facility). Phase: Therapeutic exploratory (Phase II). Countries: Spain (ended).
Therapeutic area(s): Diseases [C] - Skin and Connective Tissue Diseases [C17]
Gender: Female, Male. Age: 18-64 years, 65+ years. Enrolment: 5.
Status: Ended. Start date (EU): 2021-03-15. End date (EU): 2025-09-24. Decision date: 2024-10-18. Results received: No. Last updated: 2024-10-18.

Condition(s): chronic wounds

Source: https://euclinicaltrials.eu/ctis-public/view/2024-518789-29-00